EU clinical trial 2023-507598-16-00: PNOC022: A Combination Therapy Trial using an Adaptive Platform Design for Children and Young Adults with Diffuse Midline Gliomas (DMGs) including Diffuse Intrinsic Pontine Gliomas (DIPGs) at Initial Diagnosis, Post-Radiation Therapy and at Time of Progression
Protocol code: PNOC022
Sponsor: Prinses Maxima Centrum voor Kinderoncologie B.V. (Hospital/Clinic/Other health care facility). Phase: Therapeutic exploratory (Phase II). Countries: Netherlands (temporarily halted).
Therapeutic area(s): Diseases [C] - Neoplasms [C04]
Gender: Female, Male. Age: 0-17 years, 18-64 years. Enrolment: 30.
Status: Temporarily halted. Start date (EU): 2022-10-20. Decision date: 2024-05-21. Results received: No. Last updated: 2025-08-21.

Condition(s): Diffuse Midline Gliomas (DMGs) including Diffuse Intrinsic Pontine Gliomas (DIPGs)
Product: ONC201, Paxalisib

Primary endpoint: The primary efficacy endpoint for both Cohorts 1 and 2 is progressionfree survival at 6 months (PFS6). PFS6 is defined as the percentage of participants alive and free from progression at 6 months (26 weeks) after the initiation of the combination of the ONC201 with a novel agent given in the maintenance phase of therapy., The primary efficacy endpoint in Cohort 3 is overall survival at 7 months (OS7). OS7 is defined as the percentage of participants alive at 7 months (30 weeks) after the initiation of the combination of ONC201 with a novel agent given in the maintenance phase of therapy.

Source: https://euclinicaltrials.eu/ctis-public/view/2023-507598-16-00